EU clinical trial 2024-516746-19-00: An open-label, multi-center long-term safety roll-over study in patients with tuberous sclerosis complex (TSC) and refractory seizures who are judged by the Investigator to benefit from continued treatment with everolimus after completion of Study CRAD001M2304 (EXIST-3)
Protocol code: CRAD001M2X02B
Sponsor: Novartis Pharma AG (Pharmaceutical company). Phase: Therapeutic confirmatory (Phase III). Countries: Poland (ended).
Therapeutic area(s): Diseases [C] - Congenital, Hereditary, and Neonatal Diseases and Abnormalities [C16]
Gender: Female, Male. Age: 0-17 years, 18-64 years. Enrolment: 2.
Status: Ended. Start date (EU): 2017-08-30. End date (EU): 2025-05-14. Decision date: 2024-11-18. Results received: No. Last updated: 2025-02-14.

Condition(s): Refractory seizures associated with tuberous sclerosis complex
Product: EVEROLIMUS

Primary endpoint: Frequency and severity of AEs/SAEs
Endpoint(s): Proportion of patients with clinical benefit as assessed by the Investigator at scheduled visits

Source: https://euclinicaltrials.eu/ctis-public/view/2024-516746-19-00